EU clinical trial 2025-521269-28-00: A randomized placebo-controlled double-blind trial phase II two-arm study to investigate infarct growth over 72 hours assessed with diffusion weighted imaging on MRI after treatment with intravenous tocilizumab or placebo in patients above 18 years of age with acute ischemic stroke undergoing endovascular thrombectomy.
Protocol code: Illuminate
Sponsor: Oslo University Hospital HF (Hospital/Clinic/Other health care facility). Phase: Therapeutic exploratory (Phase II). Countries: Norway (authorised, recruitment pending), Denmark (authorised, recruitment pending).
Therapeutic area(s): Diseases [C] - Nervous System Diseases [C10]
Gender: Female, Male. Age: 18-64 years, 65+ years. Enrolment: 236.
Status: Authorised, recruitment pending. Decision date: 2026-03-12. Results received: No. Last updated: 2026-07-09.
Decision dates by country: NO: 2026-03-12, DK: 2026-07-09

Condition(s): Acute ischemic stroke
Product: RoActemra 20 mg/mL concentrate for solution for infusion, Natriumklorid B. Braun 9 mg/ml infusjonsvæske, oppløsning

Primary endpoint: ΔDWI lesion volume
Endpoint(s): DWI lesion volume, ΔFLAIR lesion volume, FLAIR lesion volume, Change in levels of brain derived (BD)-Tau, Change in levels of high-sensitivity C-reactive protein (hsCRP), NIHSS, mRS score, EQ-5D-5L domains and VAS, Occurrence of death (all-cause and stroke-related), Occurrence of symptomatic intracranial haemorrhage, Occurrence of any intracranial haemorrhage, Occurrence of any infection, Occurrence of pneumonia, Occurrence of serious adverse events, Occurrence of adverse events, Blood levels of circulating surrogate markers, Blood levels of immune activation -and inflammatory markers, Alterations in immune cell transcriptomics and genomic alterations in relation to primary and secondary endpoints., Serum concentrations of tocilizumab, Worsening of index stroke defined as (A) progression of infarct core, or haemorrhagic transformation of the index stroke, as documented by medical imaging that is (a) life-threatening requiring intervention and/or (b) results in increased disability as gauged by a ≥4-point increase from lowest NIHSS during hospitalization or (B) results in death from the index stroke., Occurence of NIHSS score 0-2, Sex difference in infarct growth, NIHSS, mRS, EQ-5D-5L domains and VAS, Mean MCA peak systolic velocity ratio, Median NIHSS, Median mRS, Rate of mortality, Mean score on EQ-5D-5L domains and VAS, Atrophy, infarct volume at MRI, Blood levels of immune activation and inflammatory markers, Rate of major cardiovascular events (MACE)

Source: https://euclinicaltrials.eu/ctis-public/view/2025-521269-28-00